EU clinical trial 2023-506335-15-00: A Phase 3, Randomized, Double blind, Placebo controlled Study to Evaluate the Effects of Oral NMRA-335140 versus Placebo in Participants with Major Depressive Disorder
Protocol code: NMRA-335140-303
Sponsor: Neumora Therapeutics Inc. (Pharmaceutical company). Phase: Therapeutic confirmatory (Phase III). Countries: Germany (ended), Bulgaria (ended), Czechia (ended), France (ended), Finland (ended), Sweden (ended), Poland (ended).
Therapeutic area(s): Psychiatry and Psychology [F] - Mental Disorders [F03]
Gender: Female, Male. Age: 18-64 years. Enrolment: 127.
Status: Ended. Start date (EU): 2024-07-18. End date (EU): 2026-06-11. End date: 2026-06-12. Decision date: 2024-06-20. Results received: No. Last updated: 2025-09-05.
Decision dates by country: FI: 2024-06-24, FR: 2024-06-28, SE: 2024-06-20, CZ: 2024-07-08, DE: 2024-06-28, PL: 2024-07-05, BG: 2024-07-01

Condition(s): Major Depressive Disorder
Product: Placebo is identical to the active NMRA-335140 but without the active drug substance to maintain study blinding., NMRA-335140

Primary endpoint: The primary endpoint is the treatment difference in change from Baseline to Week 6 in the MADRS total score.
Endpoint(s): The secondary endpoint is the change from Baseline to Week 6 assessed in the SHAPS total score.

Source: https://euclinicaltrials.eu/ctis-public/view/2023-506335-15-00